EU clinical trial 2025-522338-30-00: J6E-MC-KWAN: A Phase 2, Multicenter, Randomized, Double-Blind, Active-Controlled Study of LY4268989 (MORF-057) Co-Administered with Mirikizumab in Adults with Moderately to Severely Active Ulcerative Colitis
Protocol code: J6E-MC-KWAN
Sponsor: Eli Lilly & Co. (Pharmaceutical company). Phase: Therapeutic exploratory (Phase II). Countries: Hungary (ongoing, recruiting), Spain (authorised, recruiting), Denmark (ongoing, recruiting), Netherlands (ongoing, recruiting), Poland (ongoing, recruiting), Romania (ongoing, recruiting), Germany (authorised, recruiting), Italy (ongoing, recruiting), Austria (authorised, recruiting).
Therapeutic area(s): Diseases [C] - Digestive System Diseases [C06]
Gender: Female, Male. Age: 18-64 years, 65+ years. Enrolment: 75.
Start date (EU): 2026-03-31. Decision date: 2026-03-18. Results received: No. Last updated: 2026-06-11.
Decision dates by country: IT: 2026-03-24, RO: 2026-03-23, ES: 2026-03-20, PL: 2026-03-27, AT: 2026-06-01, DK: 2026-03-24, HU: 2026-03-27, DE: 2026-05-22, NL: 2026-05-19

Condition(s): Ulcerative Colitis
Product: Mirikizumab, Placebo to Mirikizumab, Placebo to match LY, Mirikizumab

Primary endpoint: The proportion of participants who achieve clinical remission with mMS at Week 12

Source: https://euclinicaltrials.eu/ctis-public/view/2025-522338-30-00